EU clinical trial 2024-513907-15-01: Precision psychiatry: Anti-inflammatory medication in Immuno-metabolic depression
Protocol code: NL79765.029.21
Sponsor: Amsterdam UMC Stichting (Hospital/Clinic/Other health care facility). Phase: Therapeutic confirmatory (Phase III). Countries: Netherlands (ended).
Therapeutic area(s): Psychiatry and Psychology [F] - Mental Disorders [F03]
Gender: Female, Male. Age: 18-64 years, 65+ years. Enrolment: 140.
Status: Ended. Start date (EU): 2024-10-11. End date (EU): 2026-06-19. Decision date: 2024-10-11. Results received: No. Last updated: 2024-10-11.

Condition(s): Major Depressive Disorder
Product: Placebo, Celecoxib Teva 200 mg, capsules, hard

Primary endpoint: Inventory of Depressive Symptomatology (IDS, 30-item self-report) total score during 12 week follow-up
Endpoint(s): response (50% reduction in IDS score), remission (diagnostic interview), Adverse side effects, Symptom profiles (atypical, energy-related symptoms IDS), Fatigue (CIS), Food craving (GFCQ-T), Sleep and sleep duration (ESS, sleep duration from PSQI), Anxiety symptoms (GAD7), Functioning (WHO-DAS), Pain (numeric rating scale), Therapy compliance, Change in blood levels of CRP, IL-6, TNF-α, cholesterol, triglycerides,glucose

Source: https://euclinicaltrials.eu/ctis-public/view/2024-513907-15-01